EU clinical trial 2024-517424-18-00: Efficacy study of osimertinib in treatment-naïve patients with EGFR mutant NSCLC according to TP53 mutational status (TEMPLE-2)
Sponsor: Fondazione Policlinico Universitario Agostino Gemelli IRCCS (Hospital/Clinic/Other health care facility). Phase: Therapeutic use (Phase IV). Countries: Italy (ongoing, recruitment ended).
Therapeutic area(s): Diseases [C] - Neoplasms [C04]
Gender: Female, Male. Age: 18-64 years, 65+ years. Enrolment: 54.
Status: Ongoing, recruitment ended. Start date (EU): 2022-05-10. Decision date: 2024-12-02. Results received: No. Last updated: 2024-12-02.

Condition(s): Patients with EGFR mutant NSCLC according to TP53 mutational status
Product: TAGRISSO 80 mg film-coated tablets

Primary endpoint: To determine the efficacy in terms of PFS of osimertinib in the treatment of patients with advanced EGFR mutant NSCLC, according to the TP53 mutational status.

Source: https://euclinicaltrials.eu/ctis-public/view/2024-517424-18-00